EU clinical trial 2023-505083-11-01: A Phase 2, Parallel Group, Randomized, Double-Blind, Placebo-Controlled, 3-Arm, Multicenter Treatment Study to Evaluate the Efficacy and Safety of GSK4527226 [AL101] Intravenous Infusion Compared with Placebo in Patients with Early Alzheimer’s Disease
Protocol code: 219867
Sponsor: Glaxosmithkline Research & Development Limited (Pharmaceutical company). Phase: Therapeutic exploratory (Phase II). Countries: Germany (ended), Netherlands (ended), Finland (ended), France (ended), Italy (ended), Norway (ended), Spain (ended), Sweden (ended).
Therapeutic area(s): Diseases [C] - Nervous System Diseases [C10]
Gender: Female, Male. Age: 18-64 years, 65+ years. Enrolment: 140.
Status: Ended. Start date (EU): 2024-05-07. End date (EU): 2026-04-29. Decision date: 2024-03-05. Results received: No. Last updated: 2026-04-14.
Decision dates by country: DE: 2024-03-07, FR: 2024-03-08, SE: 2024-03-05, NO: 2024-03-05, ES: 2024-03-08, FI: 2024-03-12, NL: 2024-03-11, IT: 2024-03-13

Condition(s): Alzheimer's Disease
Product: Amyvid 1900 MBq/mL solution for injection, Neuraceq 300 MBq/mL solution for injection, 0.9% (w/v) sodium chloride (Normal Saline), VIZAMYL 400 MBq/mL solution for injection, Amyvid 800 MBq/mL solution for injection

Primary endpoint: Change from baseline in CDR-SB across Weeks 52, 64 and 76.
Endpoint(s): Change from baseline across Weeks 52, 64 and 76 in: • iADRS • ADAS-Cog14 • ADCS-iADL component of ADCS-ADL-MCI • ADCS-ADL-MCI • ADCOMS

Source: https://euclinicaltrials.eu/ctis-public/view/2023-505083-11-01